EU clinical trial 2023-506698-36-00: Apa/Enza short study (Shortened 12 months duration of androgen receptor signalling agent in combination with androgen deprivation therapy in patients with low-volume metastatic castration-sensitive prostate cancer: a randomized nationwide trial
Sponsor: Erasmus Universitair Medisch Centrum Rotterdam (Erasmus MC) (Hospital/Clinic/Other health care facility). Phase: Therapeutic confirmatory (Phase III). Countries: Netherlands (ongoing, recruiting).
Therapeutic area(s): Diseases [C] - Male Urogenital Diseases [C12]; Diseases [C] - Neoplasms [C04]
Gender: Male. Age: 18-64 years, 65+ years. Enrolment: 400.
Status: Ongoing, recruiting. Start date (EU): 2024-02-02. Decision date: 2023-12-12. Results received: No. Last updated: 2025-12-03.

Condition(s): low-volume metastatic castration-sensitive prostate cancer
Product: Suprefact Depot 9,45 mg implantat, Pamorelin 11,25 mg, poeder en oplosmiddel voor suspensie voor injectie, met verlengde afgifte., Pamorelin 22,5 mg, poeder en oplosmiddel voor suspensie voor injectie, met verlengde afgifte., Pamorelin 3,75 mg, poeder en oplosmiddel voor suspensie voor injectie, met verlengde afgifte., Eligard 45 mg poeder en oplosmiddel voor oplossing voor injectie, LEUPRORELIN ACETATE, CAMCEVI 42 mg prolonged-release suspension for injection, Gonapeptyl Depot 3,75 mg poeder en oplosmiddel voor suspensie voor injectie, Eligard 22,5 mg poeder en oplosmiddel voor oplossing voor injectie, APALUTAMIDE, ELIGARD 7.5 mg powder and solvent for solution for injection, GOSERELIN ACETATE, Leuproreline Sandoz depot 3 maanden 5 mg, implantaat, ENZALUTAMIDE, Decapeptyl-CR 3,75 mg, poeder en oplosmiddel voor suspensie voor injectie, GOSERELIN ACETATE, LEUPRORELIN ACETATE, LEUPRORELIN ACETATE

Primary endpoint: Time to clinical progression free survival (cPFS) in both arms
Endpoint(s): Overall survival (OS), Time to PSA increase (defined according to PCWG3 criteria), Time to first line therapy for mCRPC, ctDNA levels correlation with PSA levels, Value of ctDNA quantification during ARSI treatment to predict tumor progression, Quality of life (QoL) in relation to treatment with ARSI, To correlate PSMA-PET scan results to clinical outcomes, Correlation of genomic profiles of previously taken prostate cancer tissue biopsies and clinical outcome., Predict patients who will need continued ARSI treatment with ctDNA levels

Source: https://euclinicaltrials.eu/ctis-public/view/2023-506698-36-00